EU clinical trial 2025-522593-36-00: A phase IV study to investigate the immunogenicity of the Seqirus licensed MF59 adjuvanted zoonotic influenza vaccine (H5N8) in adults previously vaccinated in 2009 with the Matrix M adjuvanted virosomal influenza (H5N1) vaccine compared to H5 naïve adults.
Protocol code: SEQVAC1
Sponsor: Helse Bergen HF (Hospital/Clinic/Other health care facility). Phase: Therapeutic use (Phase IV). Countries: Norway (ongoing, recruitment ended).
Therapeutic area(s): Diseases [C] - Virus Diseases [C02]
Gender: Female, Male. Age: 18-64 years, 65+ years. Enrolment: 180.
Status: Ongoing, recruitment ended. Start date (EU): 2025-10-15. Decision date: 2025-09-30. Results received: No. Last updated: 2025-11-11.
Decision dates by country: NO: 2025-11-11

Condition(s): Virus Diseases
Product: Zoonotic Influenza Vaccine Seqirus suspension for injection in pre-filled syringe Zoonotic influenza vaccine (H5N8) (surface antigen, inactivated, adjuvanted)

Primary endpoint: Serum haemagglutination inhibition (HI) antibody titres against the vaccine virus strain (H5N8 clade 2.3.4.4b) at baseline (Day 0) and 28 days after the first dose, and 28 days after the second dose (Day 56)., Serum microneutralisation (MN) antibody titres against the vaccine virus strain (H5N8 clade 2.3.4.4b) at baseline (Day 0), 28 days after the first dose, and 28 days after the second dose (Day 56)
Endpoint(s): Serum HI antibody titres against the vaccine virus strain (H5N8 clade 2.3.4.4b) 7 days after the first dose, 7 days after the second dose (Day 35), Fold increase in serum HI antibody titres against the virus strain (H5N8 clade 2.3.4.4b) 7 days and 28 days after the first dose, and 7 days and 28 days after the second dose (Day 35, Day 56), compared to baseline (Day 0), Serodetection, based on serum HI antibody titres against the virus strain (H5N8 clade 2.3.4.4b) at baseline (Day 0), 7 days and 28 days after the first dose, and 7 days and 28 days after the second dose (Day 35, Day 56), Seroconversion, based on serum HI antibody titres against the virus strain (H5N8 clade 2.3.4.4b) 7 days and 28 days after the first dose, and 7 days and 28 days after the second dose (Day 35, Day 56), compared to baseline (Day 0), Seroprotection, based on serum HI antibody titres against the virus strain (H5N8 clade 2.3.4.4b) at baseline (Day 0), 7 days and 28 days after the first dose, and 7 days and 28 days after the second dose (Day 35, Day 56), Serum MN antibody titres against the vaccine virus strain (H5N8 clade 2.3.4.4b) 7 days after the first dose, and 7 days after the second dose (Day 35), Serum HI antibody titres against heterologous variant virus strains (including H5N1 clade 1 A/Vietnam/1194/2004 and H5N1 clade 2.2.1 A/turkey/Turkey/1/2005) at baseline (Day 0), 7 days and 28 days after the first dose, and 7 days and 28 days after the second dose (Day 35, Day 56), Fold increase in serum HI antibody titres against heterologous virus strains (including H5N1 clade 1 A/Vietnam/1194/2004 and H5N1 clade 2.2.1 A/turkey/Turkey/1/2005) 7 days and 28 days after the first dose, and 7 days and 28 days after the second dose (Day 56), compared to baseline (Day 0), Serodetection, based on serum HI antibody titres against heterologous virus strains (H5N1 clade 1 A/Vietnam/1194/2004 and H5N1 clade 2.2.1 A/turkey/Turkey/1/2005) at baseline (Day 0), 7 days and 28 days after the first dose, and 7 days and 28 days after the second dose (Day 35, Day 56), Seroconversion, based on serum HI antibody titres against heterologous virus strains (including to H5N1 clade 1 A/Vietnam/1194/2004 and H5N1 clade 2.2.1 A/turkey/Turkey/1/2005) 7 days and 28 days after the first dose, and 7 days and 28 days after the second dose (Day 35, Day 56), compared to baseline (Day 0), Seroprotection, based on serum HI antibody titres against heterologous virus strains (including to H5N1 clade 1 A/Vietnam/1194/2004 and H5N1 clade 2.2.1 A/turkey/Turkey/1/2005) at baseline (Day 0), 7 days and 28 days after the first dose, and 7 days and 28 days after the second dose (Day 35, Day 56), Serum MN antibody titres against heterologous virus strains (including H5N1 clade 1 A/Vietnam/1194/2004 and H5N1 clade 2.2.1 A/turkey/Turkey/1/2005) at baseline (Day 0), 7 days and 28 days after the first dose, and 7 days and 28 days after the second dose (Day 35, Day 56), Occurrence of all serious adverse events (SAEs) from the day of vaccination up to the study end, Occurrence of all SAEs related to study intervention from the day of vaccination up to the study end

Source: https://euclinicaltrials.eu/ctis-public/view/2025-522593-36-00